EU clinical trial 2023-505223-31-00: EORTC-1745-ETF-BCG: A Phase II study of Adjuvant PALbociclib as an Alternative to CHemotherapy in Elderly patientS with high-risk ER+/HER2- early breast cancer (APPALACHES)
Protocol code: EORTC-1745-ETF-BCG
Sponsor: European Organisation For Research And Treatment Of Cancer (Patient organisation/association). Phase: Therapeutic exploratory (Phase II). Countries: Spain (ongoing, recruitment ended), Germany (ongoing, recruitment ended), Portugal (ongoing, recruitment ended), Poland (ongoing, recruitment ended), Belgium (ongoing, recruitment ended), Italy (ongoing, recruitment ended), France (ongoing, recruitment ended).
Therapeutic area(s): Diseases [C] - Neoplasms [C04]
Gender: Female, Male. Age: 65+ years. Enrolment: 347.
Status: Ongoing, recruitment ended. Start date (EU): 2019-06-14. Decision date: 2024-02-21. Results received: No. Last updated: 2026-05-13.
Decision dates by country: BE: 2024-02-22, FR: 2024-03-13, DE: 2024-02-21, IT: 2024-02-23, PT: 2024-03-25, ES: 2024-03-21, PL: 2024-02-25

Condition(s): Localized ER+ breast cancer
Product: IBRANCE 75 mg hard capsules, EXEMESTANE, IBRANCE 125 mg hard capsules, IBRANCE 100 mg hard capsules, IBRANCE 75 mg film-coated tablets, IBRANCE 125 mg hard capsules, IBRANCE 75 mg film-coated tablets, TAMOXIFEN, IBRANCE 75 mg film-coated tablets, IBRANCE 100 mg film-coated tablets, IBRANCE 125 mg film-coated tablets, IBRANCE 125 mg hard capsules, ANASTROZOLE, IBRANCE 75 mg hard capsules, CYCLOPHOSPHAMIDE, DOCETAXEL, IBRANCE 100 mg hard capsules, IBRANCE 100 mg film-coated tablets, IBRANCE 100 mg hard capsules, PACLITAXEL, IBRANCE 100 mg film-coated tablets, DOXORUBICIN, IBRANCE 125 mg film-coated tablets, IBRANCE 125 mg film-coated tablets, EPIRUBICIN HYDROCHLORIDE, IBRANCE 75 mg hard capsules, LETROZOLE

Primary endpoint: The primary endpoint in this study is the 3-year distant recurrence-free interval rate in the experimental arm.
Endpoint(s): Distant recurrence-free interval at 3 years in the control arm., Breast cancer specific survival at 3 years in both arms., Overall survival at 3 years in both arms., Adverse events according to CTCAE v5.0 recorded at every patient visit in both arms., Treatment discontinuation and dose reduction rates in both arms., Reason for treatment discontinuation., HRQoL questionnaires (modified QLQ-C30, ELD-14, and selected items from the BR45 module) at 3 months, 6 months, 1 year, 2 years, and 3 years in both arms., Geriatric assessment tools (G8, iADL, ADL, Gait speed, CCI, social situation) at 3 months, 6 months, 1 year, 2 years, and 3 years in both arms.

Source: https://euclinicaltrials.eu/ctis-public/view/2023-505223-31-00